EU clinical trial 2024-511963-28-00: An Open-Label Multicenter Phase 1b Study of Tolinapant (ASTX660) in Combination With Radiotherapy/Chemoradiotherapy (RT/CRT) in Preoperative Treatment of Patients With Rectum Cancer (PRAAR 1: Preoperative Radiotherapy And ASTX660 in Rectum Cancer)
Protocol code: CSET N°2021/3339
Sponsor: Institut Gustave Roussy (Hospital/Clinic/Other health care facility). Phase: Human Pharmacology (Phase I)- Other. Countries: France (ongoing, recruitment ended).
Therapeutic area(s): Diseases [C] - Pathological Conditions, Signs and Symptoms [C23]; Diseases [C] - Digestive System Diseases [C06]; Diseases [C] - Immune System Diseases [C20]
Gender: Female, Male. Age: 18-64 years, 65+ years. Enrolment: 78.
Status: Ongoing, recruitment ended. Start date (EU): 2023-12-19. Decision date: 2024-06-10. Results received: No. Last updated: 2024-06-10.

Condition(s): Neoadjuvant therapy in locally-advanced rectal cancer

Source: https://euclinicaltrials.eu/ctis-public/view/2024-511963-28-00